EU clinical trial 2024-518298-33-00: A phase I trial of IMA970A plus Montanide in combination with Durvalumab (anti-PD-L1) in patients with very early, early and intermediate stage of hepatocellular carcinoma after any standard treatments.
Protocol code: HepaVac-201
Sponsor: IRCCS Istituto Nazionale Tumori Fondazione Pascale (Hospital/Clinic/Other health care facility). Phase: Human Pharmacology (Phase I)- Other. Countries: Italy (ongoing, recruitment ended).
Therapeutic area(s): Diseases [C] - Neoplasms [C04]
Gender: Female, Male. Age: 18-64 years, 65+ years. Enrolment: 10.
Status: Ongoing, recruitment ended. Start date (EU): 2022-11-21. Decision date: 2024-11-11. Results received: No. Last updated: 2025-04-08.

Condition(s): Hepatocellular carcinoma

Source: https://euclinicaltrials.eu/ctis-public/view/2024-518298-33-00